EU clinical trial 2025-524423-50-00: An open-label, single-arm, phase 1/2 first-in-human study to assess the safety and efficacy of autologous CD34+ cells transduced with a lentiviral vector encoding the human NCF1 gene (SGX-001) in paediatric and adult patients with chronic granulomatous disease caused by p47phox deficiency
Protocol code: SGX-001-CT-01
Sponsor: Somagenetix AG (Pharmaceutical company). Phase: Phase I and Phase II (Integrated)- First administration to humans. Countries: Germany (authorised, recruitment pending), Spain (authorised, recruitment pending).
Therapeutic area(s): Diseases [C] - Congenital, Hereditary, and Neonatal Diseases and Abnormalities [C16]
Gender: Female, Male. Age: 0-17 years, 18-64 years. Enrolment: 4.
Status: Authorised, recruitment pending. Decision date: 2026-05-29. Results received: No. Last updated: 2026-06-01.
Decision dates by country: DE: 2026-05-29, ES: 2026-06-01

Condition(s): Chronic granulomatous disease (CGD) caused by p47phox deficiency (p47-CGD)
Product: autologous CD34+ cells transduced with a lentiviral vector encoding the human NCF1 gene

Primary endpoint: Safety endpoints until Month 12 presented overall and/or by study stage or visit (as applicable), including: • TEAEs • SAEs • SAEs related to SGX-001 • AESIs • TEAEs by intensity grade • Discontinuations due to TEAEs • Laboratory assessments • Vital signs • 12 lead ECGs • Physical examinations, Participants with response to the treatment with SGX-001 (defined as NADPH oxidase activity in ≥ 10% of peripheral blood granulocytes) at Month 12
Endpoint(s): Overall survival at Month 12, % ox-DHR+ in peripheral blood granulocytes and change in stimulation index from screening to Month 12, Number and type of new CGD-typic infections to Month 12, Number of participants off antibacterial prophylaxis at Month 12, Number of participants on antibacterial therapy in participants treated with SGX 001, Duration of antibacterial therapy in participants treated with SGX-001, Indication for antibacterial therapy in participants treated with SGX-001, Number of participants off antifungal prophylaxis at Month 12, Number of participants on antifungal therapy in participants treated with SGX 001, Duration of antifungal therapy in participants treated with SGX 001, Indication for antifungal therapy in participants treated with SGX-001, Number of participants not requiring treatment with IFN gamma at Month 12, Number of participants not requiring treatment with systemic immunosuppression at Month 12, Change from baseline in the presence or severity of IBD, Change from baseline to Month 12 in the presence or severity of inflammatory manifestations, Number of participants recovered from pre-existing active infection at Month 12, Number of participants with improved HRQoL at Month 12, Incidence of primary graft failure, Incidence of secondary graft failure, Transgene level in bone marrow cells at Months 6 and 12, Transgene level in peripheral blood cells at Months 1, 2, 3, 6, 9, and 12, Time to neutrophil recovery, Incidence of neutrophil recovery by D 42 after SGX 001 infusion, Time to platelet recovery, Incidence of platelet recovery at Month 12, Incidence of clonal dominance events in blood and bone marrow at Months 6 and 12, Incidence of detectable RCL at Months 3, 6, and 12

Source: https://euclinicaltrials.eu/ctis-public/view/2025-524423-50-00